EU clinical trial 2024-514331-24-00: Contribution of PET/CT with Gallium 68 citrate (68Ga-PET/CT) for the diagnosis of prosthetic valve infective endocarditis - CiGal-EI-TEP
Protocol code: CHUBX 2020/49
Sponsor: Centre Hospitalier Universitaire De Bordeaux (Hospital/Clinic/Other health care facility). Phase: Therapeutic exploratory (Phase II). Countries: France (ongoing, recruiting).
Therapeutic area(s): Analytical, Diagnostic and Therapeutic Techniques and Equipment [E] - Investigative Techniques [E05]
Gender: Female, Male. Age: 18-64 years, 65+ years. Enrolment: 40.
Status: Ongoing, recruiting. Start date (EU): 2024-11-22. Decision date: 2024-07-04. Results received: No. Last updated: 2025-11-04.

Condition(s): Prosthetic valve infective endocarditis
Product: 68 Gallium citrate

Primary endpoint: Sensitivity of 68Ga-PET/CT for the diagnosis of prosthetic valve infective endocarditis in patients suspected of infective endocarditis on prosthetic valve
Endpoint(s): Specificity, positive and negative predictive values of 68Ga-PET/CT for the diagnosis of infective endocarditis on prosthetic valve in patients suspected of infective endocarditis on prosthetic valve, Cohen's kappa for inter-observer reproducibility of 68Ga-PET/CT for the diagnosis of infective endocarditis on prosthetic valve in patients suspected of infective endocarditis on prosthetic valve, Sensitivity, specificity and positive and negative predictive values of 18FDG-PET/CT for the diagnosis of infective endocarditis on prosthetic valve, Discrepancies between 68Ga-PET/CT and 18FDG-PET/CT for the evaluation of the spread of infection assessment and the search for the initial portal of pathogen entry

Source: https://euclinicaltrials.eu/ctis-public/view/2024-514331-24-00